EU clinical trial 2025-520910-67-01: A randomized, Phase 4, double-blind, placebo-controlled, 6-arm crossover study to investigate the systemic effect of lidocaine and ropivacaine when used for Transversus Abdominis Plane (TAP) blocks on hyperalgesia and pain perception in healthy volunteers aged 18 to 64 years.
Protocol code: LASER
Sponsor: Oslo University Hospital HF (Hospital/Clinic/Other health care facility). Phase: Therapeutic use (Phase IV). Countries: Norway (authorised, recruitment pending).
Therapeutic area(s): Analytical, Diagnostic and Therapeutic Techniques and Equipment [E] - Anesthesia and Analgesia [E03]
Gender: Male. Age: 18-64 years. Enrolment: 20.
Status: Authorised, recruitment pending. Decision date: 2026-05-28. Results received: No. Last updated: 2026-05-28.

Condition(s): Acute pain
Product: ROPIVACAINE, SODIUM CHLORIDE, LIDOCAINE HYDROCHLORIDE

Primary endpoint: Area of pinprick hyperalgesia induced by electrical stimulation
Endpoint(s): Pain intensity induced by electrical stimulation, Cuff-pressure pain tolerance threshold, Pain detection threshold tested by cuff-pressure algometry, Local anaesthetic plasma concentrations, Blood pressure, Heart rate, Subjective experience of LA side effects, Report of all adverse events

Source: https://euclinicaltrials.eu/ctis-public/view/2025-520910-67-01